EU clinical trial 2024-510629-24-00: Management of peripheral levodopa resistance in Parkinson’s disease
Sponsor: Stichting Radboud University Medical Center (Patient organisation/association). Phase: Therapeutic exploratory (Phase II). Countries: Netherlands (ongoing, recruiting).
Therapeutic area(s): Diseases [C] - Nervous System Diseases [C10]
Gender: Female, Male. Age: 18-64 years, 65+ years. Enrolment: 81.
Status: Ongoing, recruiting. Start date (EU): 2025-05-14. Decision date: 2024-12-16. Results received: No. Last updated: 2026-02-04.

Condition(s): Parkinson's disease
Product: Domperidon Accord 10 mg, tabletten, XIFAXAN 550 mg filmomhulde tabletten, Dacepton 10 mg/ml oplossing voor injectie in een patroon, Placebo capsules, Madopar 125 mg, dispergeerbare tabletten

Primary endpoint: Proportion of responders (defined as >30.0% decrease in MDS-UPDRS-III compared to pre-treatment), apomorphine versus levodopa, MDS-UPDRS-IIIΔOFF-ONΔposttreatment-pretreatment, rifaximin compared to placebo
Endpoint(s): MDS-UPDRS IIIΔOFF-ON, Composite Clinical Motor Score (CCMS), Modified Hoehn & Yahr scale, Global Rating of Change (GRC), Modified GIDS-PD

Source: https://euclinicaltrials.eu/ctis-public/view/2024-510629-24-00